EU clinical trial 2024-513074-22-00: Neoadjuvant nivolumab combination treatment in resectable non-small cell lung cancer patients: Defining optimal combinations and determinants of immunological response (NEOpredict-Lung)
Protocol code: CA224-063
Sponsor: Universitaetsklinikum Essen AöR (Hospital/Clinic/Other health care facility). Phase: Therapeutic exploratory (Phase II). Countries: Netherlands (ended), Germany (ended), Belgium (ended).
Therapeutic area(s): Diseases [C] - Neoplasms [C04]
Gender: Female, Male. Age: 18-64 years, 65+ years. Enrolment: 90.
Status: Ended. Start date (EU): 2019-12-02. End date (EU): 2025-11-27. Decision date: 2024-06-18. Results received: No. Last updated: 2025-10-23.
Decision dates by country: BE: 2024-08-12, NL: 2024-06-21, DE: 2024-06-24

Condition(s): non-small cell lung cancer (NSCLC) of clinical stages IB, II and selected stage III A
Product: Relatlimab intravenous, OPDIVO 10 mg/mL concentrate for solution for infusion.

Primary endpoint: Primary variable is the number of patients undergoing curatively intended surgery of non-small cell lung cancer within 43 days of initiation of study therapy.
Endpoint(s): Objective response rate (RECIST 1.1), Pathological response rate per ypTNM classification and per IASLC recommendations [..], R0 resection rate, Disease-free survival rate at 12 months per RECIST 1.1, Overall survival rate at 12 months, Safety and tolerability of preoperative immunotherapy, Morbidity and mortality within 90 days of curative surgery, Translational parameters [..]

Source: https://euclinicaltrials.eu/ctis-public/view/2024-513074-22-00